EU clinical trial 2023-507468-38-00: A Phase 2 Open-Label Study to Evaluate the Safety, Tolerability, Pharmacokinetics, and Efficacy of KER-050 as Monotherapy or in Combination with Ruxolitinib in Participants with Myelofibrosis.
Protocol code: KER050-MF-301
Sponsor: Takeda Development Center Americas Inc. (Pharmaceutical company). Phase: Therapeutic exploratory (Phase II). Countries: Spain (ongoing, recruitment ended), France (ongoing, recruitment ended), Italy (ongoing, recruitment ended).
Therapeutic area(s): Diseases [C] - Hemic and Lymphatic Diseases [C15]
Gender: Female, Male. Age: 18-64 years, 65+ years. Enrolment: 47.
Status: Ongoing, recruitment ended. Start date (EU): 2022-04-22. Decision date: 2024-09-02. Results received: No. Last updated: 2026-05-22.
Decision dates by country: IT: 2024-09-11, ES: 2024-09-02, FR: 2024-09-03

Condition(s): Myelofibrosis
Product: Jakavi 10 mg tablets, Jakavi 10 mg tablets, Jakavi 20 mg tablets, Jakavi 5 mg tablets, elritercept, Jakavi 20 mg tablets, Jakavi 20 mg tablets, Jakavi 10 mg tablets, Jakavi 5 mg tablets, Jakavi 5 mg tablets

Primary endpoint: Part 1 Dose Escalation: •Safety and tolerability as determined by the incidence of adverse events (AEs), including dose-limiting toxicities (DLTs), severe AEs, and serious AEs (SAEs), Part 2 Dose Expansion: •Safety and tolerability as determined by the incidence of AEs, including severe AEs and SAEs, Long-Term Extension: •Safety and tolerability as determined by the incidence of AEs, including severe AEs and SAEs over time
Endpoint(s): Proportion of participants with progression to AML, Proportion of participants with progression to accelerated MF, Subgroup of participants with anemia requiring red blood cell (RBC) transfusions (See Table 3 in Protocol KER050-MF-301 v 6.0)., Subgroup of transfusion-independent participants (and, when appropriate, the subgroup of participants with anemia requiring RBC transfusions who are deemed not evaluable for assessment of transfusion independence) (See Table 3 Protocol KER050-MF-301 v 6.0)., Proportion of participants with improvement in the MF-SAF (v4.0)-TSS of ≥50% from baseline at Week 24, Proportion of participants with decrease in spleen volume of ≥35% from baseline as measured by computed tomography/magnetic resonance imaging (CT/MRI) at Week 24 (excluding participants’ status post splenectomy or splenic irradiation), Plasma concentrations of elritercept, Maximum observed serum concentration (Cmax), time to maximum observed concentration (Tmax), and area under the concentration-time curve from time 0 to the time of last quantifiable concentration (AUC0-last; Cycle 1 only), Minimum observed serum concentration (Cmin) and accumulation rate (Rac), Change from baseline of red cell parameters, including reticulocyte count, Hgb, mean corpuscular volume, mean corpuscular hemoglobin, and reticulocyte cell Hgb by visit

Source: https://euclinicaltrials.eu/ctis-public/view/2023-507468-38-00